EU clinical trial 2025-521619-37-00: NACRE 2_Randomized phase III study evaluating two treatment strategies for locally advanced rectal cancer in patients ≥75 years old
Protocol code: UC-GIG-2408
Sponsor: Unicancer (Hospital/Clinic/Other health care facility). Phase: Therapeutic confirmatory (Phase III). Countries: France (authorised, recruitment pending).
Therapeutic area(s): Diseases [C] - Neoplasms [C04]
Gender: Female, Male. Age: 65+ years. Enrolment: 160.
Status: Authorised, recruitment pending. Decision date: 2026-02-02. Results received: No. Last updated: 2026-06-02.

Condition(s): Patients ≥75 years old with cT3/T4 rectal adenocarcinoma eligible to radiotherapy, FOLFOX chemotherapy and total mesorectal excision (TME) surgery
Product: OXALIPLATIN, FOLINIC ACID, CALCIUM LEVOFOLINATE, FLUOROURACIL

Primary endpoint: The 24-months TME-free survival will be estimated with the Kaplan-Meier method and presented with its 95% confidence interval. Organ preservation rate at 24 months, defined as proportion of patients without TME, or nonsalvageable pelvic disease, and without permanent diversion stoma. Patients alive at the time of analysis or lost from follow-up will be censored at the date of the latest news.
Endpoint(s): Rate of cCR will be defined as percentage of CR confirmed by central review after 21 weeks divided by the number of patients. CR is defined as flat, white scar, with telangiectasia, no ulcer or nodularity on endoscopic evaluation, no induration on digital rectal examination, normal appearing bowel wall without any fibrosis in the tumor bed, dark T2 signal, no mesorectal lymph node on pelvic MRI-T2W, no visible signal on B800-B1000 MRI-DW, no metastatic dissemination on chest, abdominal CT scan, The 24-month overall survival defined as the period between the date of randomization and the date of death related to the cancer. Patients who did not die at the time of analysis or are lost-of-follow-up will be censored at the date of the latest news. The 24-months OS will be estimated with the Kaplan-Meier method and presented with its 95% confidence interval., Locoregional failure at 24 months, defined as either an unresectable rectal primary tumor following protocol neoadjuvant treatment, an R2 resection for the rectal primary tumor, or recurrence in the primary tumor bed after an R0-R1 resection. Tumor regrowth in the rectal wall or in regional lymph nodes after a cCR or near-complete response, a period of Watch & Wait or after local scar excision (for ypT0 and T1 tumor) will not be considered a locoregional failure if followed by an R0-R1 resection, The 24-months disease-free survival defined as the period between the date of randomization and the date of locoregional failure (as described above), distant metastasis, a new invasive colorectal primary cancer, or death from any cause. The 24-months DFS will be estimated with the Kaplan-Meier method and presented with its 95% confidence interval., 24-month Regrowth Rate will be defined as the proportion of patients presenting tumor regrowth during their surveillance in the “watch and wait” strategy or after local scar excision after they achieved cCR., The 24-month metastasis-free survival will be defined as the period between the date of randomization and the date of detection of distant metastasis. The 24-months MFS will be estimated with the Kaplan-Meier method and presented with its 95% confidence interval., Rate of R0 resection will be defined as the percentage of R0 resection among patients with TME surgery (for patient with surgery only), Rate of postoperative complications of initial surgery will be assessed at 3 months using Clavien-Dindo classification (for patient with surgery only), Rate of postoperative complications of salvage surgery after initial NOM will be assessed at 3 months using Clavien-Dindo classification (for patient with surgery only), The safety profile in each arm will be described using the common toxicity criteria from the CTCAE v5.0., The Bowel function will be assessed using the LARS score at inclusion, 3 months postradiotherapy, 12 months and 24 months post inclusion., Quality of life will be assessed by QLQ-C30 and ELD-14 score at inclusion, 3 months postradiotherapy, 12 months and 24 months post inclusion., Geriatric assessment will be evaluated using G8, MMS, ADL, IADL, TUG, Charlson, ACE 27, SARC F, Hand grip, 5-time chair, G Code at inclusion, then G Code at 3 months post radiotherapy, 12 and 24 months post inclusion

Source: https://euclinicaltrials.eu/ctis-public/view/2025-521619-37-00